EU clinical trial 2023-503403-28-00: A phase 2 trial of neoadjuVAnt muLti-agENT chemotherapy or patritumab deruxtecan (HER3-DXd; U3-1402) with or without endocrINE therapy for high-risk HR+/HER2- breast cancer – VALENTINE trial
Protocol code: SOLTI-2103
Sponsor: Solti Group (Pharmaceutical company). Phase: Therapeutic exploratory (Phase II). Countries: Spain (ongoing, recruitment ended).
Therapeutic area(s): Diseases [C] - Neoplasms [C04]
Gender: Female, Male. Age: 18-64 years, 65+ years. Enrolment: 120.
Status: Ongoing, recruitment ended. Start date (EU): 2022-11-25. Decision date: 2024-01-18. Results received: No. Last updated: 2025-11-05.

Condition(s): treatment naïve patients with HR+/HER2-negative high-risk early breast cancer.
Product: Patritumab deruxtecan (U3-1402)

Primary endpoint: Rate of pCRBL (ypT0/is ypN0) at surgery, defined as the complete absence of invasive carcinoma in the breast and axillary lymph nodes on histological examination
Endpoint(s): Rate of Residual cancer burden (RCB) category status (0, I, II, III) assessed by a local pathologist at surgery according to the MD Anderson Cancer Center recommendations., pCRB defined as the complete absence of invasive carcinoma in the breast on histological examination after treatment, irrespective of in situ carcinoma in the breast., Tumor overall objective response rate (ORR), defined as the proportion of subjects with a Partial Responses (PR) or a Complete Responses (CR) according to RECIST v1.1, as per Investigator's assessments by breast MRI before treatment and pre-surgery., iDFS rate at 3 years follow-up, iDFS rate at 5 years follow-up, Change in CelTIL score from baseline to C2D1., The Correlation of CelTIL changes from baseline to C2D1 with: pCR, RCB, ORR and iDFS., The correlation of pCR with both HER3 receptor expression levels by IHC at baseline and ERBB3 mRNA expression level by gene expression at baseline., The correlation of pCR with changes of HER3 receptor expression levels by IHC and ERBB3 mRNA expression level by gene expression between baseline and C2D1., Change in Ki67 IHC from baseline to C2D1., and correlation of Ki67 IHC changes from baseline to C2D1 with: pCR, RCB, ORR and iDFS., Type, incidence, severity (as graded by the NCI CTCAE v. 5.0), seriousness, moment of onset, duration and attribution to the study medications of TEAEs, AESI and any laboratory abnormalities., Change from baseline in EORTC QLQ-C30 and EORTC QLQ BR23 scores.

Source: https://euclinicaltrials.eu/ctis-public/view/2023-503403-28-00